EU clinical trial 2023-505890-34-00: Study of Empagliflozin in Patients with Autosomal Dominant Polycystic Kidney Disease
Sponsor: Medizinische Hochschule Hannover (Educational Institution). Phase: Therapeutic use (Phase IV). Countries: Germany (ongoing, recruitment ended).
Therapeutic area(s): Not possible to specify
Gender: Female, Male. Age: 18-64 years, 65+ years. Enrolment: 44.
Status: Ongoing, recruitment ended. Start date (EU): 2024-06-27. Decision date: 2024-03-05. Results received: No. Last updated: 2025-09-30.

Condition(s): Autosomal dominant polycystic kidney disease
Product: Jardiance 10 mg film-coated tablets, Placebo

Primary endpoint: Relative change from baseline total kidney volume (TKV) to month 18 of treatment (%/year).

Source: https://euclinicaltrials.eu/ctis-public/view/2023-505890-34-00